EU clinical trial 2024-517262-41-00: A Phase 3, Multicenter, Double-blind, Placebo-controlled, Randomized Withdrawal Trial to Evaluate the Efficacy, Safety, and Pharmacokinetics of Deucravacitinib in Children and Adolescents from 5 to less than 18 Years of Age with Active Juvenile Psoriatic Arthritis
Protocol code: IM011-1071
Sponsor: Bristol-Myers Squibb Services Unlimited Company (Pharmaceutical company). Phase: Therapeutic confirmatory (Phase III). Countries: Italy (authorised, recruitment pending), Czechia (ongoing, recruiting), Bulgaria (ongoing, recruiting), Romania (ongoing, recruiting), Spain (authorised, recruiting), Germany (ongoing, recruiting).
Therapeutic area(s): Diseases [C] - Musculoskeletal Diseases [C05]
Gender: Female, Male. Age: 0-17 years. Enrolment: 29.
Start date (EU): 2025-02-28. Decision date: 2025-02-18. Results received: No. Last updated: 2026-04-22.
Decision dates by country: CZ: 2025-02-18, RO: 2025-02-28, DE: 2025-05-16, ES: 2025-02-28, IT: 2025-02-19, BG: 2025-02-28

Condition(s): Juvenile Psoriatic Arthritis (JPsA)
Product: deucravacitinib, deucravacitinib, Deucravacitinib placebo 2mg film-coated tablets in sachet, oral use, deucravacitinib

Primary endpoint: To see how long it takes for the first flare-up of the disease to happen between weeks 16 to 42 in participants who take the medication compared to participants who stopped taking the drug., To see how long it takes for the first flare-up of the disease to happen between weeks 16 to 42 in participants who take the medication compared to participants who stopped taking the drug.
Endpoint(s): Evaluating amount of deucravacitinib in the body at week 16., Assessing how many participants have a flare-up and how many reach different levels of improvement at weeks 16 and 42. Assessing how much the disease has improved from start of the trial and how many have low disease activity or no disease activity at weeks 16 and 42. Assessing how many participants have no disease activity for at least 6 months in a row. Assessing how many have a 75% improvement in their skin symptoms by week 42, Assessing how many participants find the medicine easy to swallow and taste good at week 16., Assessing how the amount of medicine in the body affects the results at week 16., Monitoring any side effects, how severe they are, and if they cause anyone to stop the trial. Assessing how many participants develop an eye condition called uveitis., Evaluating amount of deucravacitinib in the body at week 16., Seeing how many people have a flare-up between weeks 16 to 42., Assessing how many participants find the medicine easy to swallow and taste good at week 16., Assessing how the amount of medicine in the body affects the results at week 16., Monitoring any side effects, how severe they are, and if they cause anyone to stop the trial. Assessing how many participants develop an eye condition called uveitis.

Source: https://euclinicaltrials.eu/ctis-public/view/2024-517262-41-00